EU clinical trial 2023-508130-33-00: C4891026 - AN INTERVENTIONAL SAFETY AND EFFICACY PHASE 1B/2, OPEN-LABEL STUDY TO INVESTIGATE TOLERABILITY, PK, AND ANTITUMOR ACTIVITY OF VEPDEGESTRANT (ARV-471/PF-07850327), AN ORAL PROTEOLYSIS TARGETING CHIMERA, IN COMBINATION WITH PF-07220060 IN PARTICIPANTS AGED 18 YEARS AND OLDER WITH ER+/HER2- ADVANCED OR METASTATIC BREAST CANCER
Protocol code: C4891026
Sponsor: Pfizer Inc. (Pharmaceutical company). Phase: Phase I and Phase II (Integrated)- Other. Countries: France (ongoing, recruitment ended), Belgium (ongoing, recruitment ended), Spain (ongoing, recruitment ended).
Therapeutic area(s): Diseases [C] - Neoplasms [C04]
Gender: Female, Male. Age: 18-64 years, 65+ years. Enrolment: 26.
Status: Ongoing, recruitment ended. Start date (EU): 2024-07-03. Decision date: 2024-04-29. Results received: No. Last updated: 2026-05-29.
Decision dates by country: BE: 2024-05-06, ES: 2024-04-29, FR: 2024-05-06

Condition(s): ADVANCED OR METASTATIC BREAST CANCER
Product: PF-07850327 round

Primary endpoint: Phase 1b: DLTs during DLT observation period (Cycle 1)., Phase 2: Confirmed OR (CR or PR) determined by investigator assessment.
Endpoint(s): Phase 1b: -AEs as characterized by type, frequency, intensity (as graded by NCI CTCAE version 5.0), seriousness, and relationship to vepdegestrant in combination with PF-07220060; -Incidence of laboratory abnormalities. -Incidence of ECG abnormalities., Phase 1b: -Confirmed OR (CR or PR) by investigator assessment. -DoR by investigator assessment. -CBR (confirmed CR or PR at any time, or SD ≥24 weeks) by investigator assessment.-PFS by investigator assessment., Phase 1b: -Plasma concentrations of vepdegestrant, ARV-473, and PF-07220060. -Steady-state Cmax, Tmax, and AUClast of vepdegestrant, ARV-473, and PF-07220060. -If data permit CL/F, Vz/F, and t½ of vepdegestrant, ARV-473, and PF- 07220060., Phase 2: -DoR by investigator assessment. -CBR (confirmed CR or PR at any time or SD ≥24 weeks) by investigator assessment. -PFS by investigator assessment. -OS., Phase 2: -AEs as characterized by type, frequency, intensity (as graded by NCI CTCAE version 5.0), seriousness, and relationship to vepdegestrant in combination with PF-07220060. -Incidence of laboratory abnormalities. -Incidence of ECG abnormalities, Phase 2: Plasma concentrations of vepdegestrant, ARV-473, and PF-07220060., Phase 2: ctDNA plasma quantitative changes from pre-treatment to evaluate potential predictability of their associations with clinical outcomes.

Source: https://euclinicaltrials.eu/ctis-public/view/2023-508130-33-00